EU clinical trial 2024-512829-81-00: Efficacy and Safety of cangrelor on top of anticoagUlation in patients with myocaRdial infarction related cardiogenic shock/cardiac arrest receiVIng VA-ECMO and/or Impella support – a phase 2, single arm, single center trial
Sponsor: Ospedale San Raffaele S.r.l. (Hospital/Clinic/Other health care facility). Phase: Therapeutic exploratory (Phase II). Countries: Italy (ongoing, recruiting).
Therapeutic area(s): Diseases [C] - Cardiovascular Diseases [C14]
Gender: Female, Male. Age: 18-64 years, 65+ years. Enrolment: 50.
Status: Ongoing, recruiting. Start date (EU): 2024-04-10. Decision date: 2024-05-02. Results received: No. Last updated: 2024-12-06.

Condition(s): Adult patients treated in VA ECMO/Impella for cardiogenic shock/cardiac arrest undergoing PCI. Given the high incidence of bleeding from conventional antithrombotic therapy, the use of readily available and rapidly metabolized cangrelor should result in adequate efficacy and increased safety. Patients will receive scoagulation with bivalirudin (target apt 55-70 seconds) and cangrelor with starting dose 0.125 mcg/kg/min and adjusted with step +/- 0.125 mcg/kg/min.
Product: Kengrexal 50 mg powder for concentrate for solution for injection/infusion

Primary endpoint: Efficacy and safety clinical endpoint will be the occurrence of thrombotic adverse events and bleeding adverse events, respectively, during the time of cangrelor infusion (see text for adverse events definition)., Safety primary endpoint will be the occurrence of major bleeding events. Major bleeding will be defined as: type 3b or 5 Bleeding Academic Research Consortium (BARC) bleeding.

Source: https://euclinicaltrials.eu/ctis-public/view/2024-512829-81-00